EU clinical trial 2022-502000-73-00: A Randomized, Double-blind, Placebo-Controlled, Multicenter Phase 3 Study to Evaluate the Safety, Tolerability, and Efficacy of XEN1101 as Adjunctive Therapy in Focal-Onset Seizures
Protocol code: XPF-010-301
Sponsor: Xenon Pharmaceuticals Inc. (Pharmaceutical company). Phase: Therapeutic confirmatory (Phase III). Countries: Spain (ended), Poland (ended), Bulgaria (ended), Italy (ended), Germany (ended), Ireland (ended), Czechia (ended), Latvia (ended), Portugal (ended).
Therapeutic area(s): Diseases [C] - Nervous System Diseases [C10]
Gender: Female, Male. Age: 18-64 years, 65+ years. Enrolment: 168.
Status: Ended. Start date (EU): 2023-08-11. End date (EU): 2026-01-09. End date: 2026-02-03. Decision date: 2023-04-19. Results received: No. Last updated: 2025-09-30.
Decision dates by country: BG: 2023-04-24, LV: 2024-11-29, PT: 2024-11-12, IT: 2023-04-19, CZ: 2024-12-06, DE: 2024-04-09, ES: 2023-04-24, IE: 2024-11-29, PL: 2023-04-24

Condition(s): Focal Onset Seizures
Product: XPF-010, XPF-010, XPF-010, XEN1101 placebo drug product consists of a size 3 white opaque HPMC capsule (Capsugel VCaps® Plus White OP) containing 10mg of Avicel® PH102 (microscrystaline cellulose), XPF-010

Primary endpoint: Proportion of subjects experiencing ≥50% reduction in monthly (28 days) focal seizure frequency from baseline through the DBP for XEN1101 versus placebo
Endpoint(s): MPC in monthly (28 days) focal seizure frequency from baseline through the DBP for XEN1101 versus placebo, Proportion of subjects experiencing ≥50% reduction in weekly (7 days) focal seizure frequency from baseline to Week 1., Proportion of subjects experiencing “at least much improved” (including “much” and “very much improved”) in PGI-C at Week 12.

Source: https://euclinicaltrials.eu/ctis-public/view/2022-502000-73-00